EU clinical trial 2024-516193-30-01: A single-arm, open-label, multi-centre, phase I/II study evaluating the safety and clinical activity of QEL-001, an autologous CAR T regulatory cell treatment targeting HLA-A2, in HLA-A2/ A28neg patients that have received an HLA-A2pos liver transplant.
Protocol code: QEL-001-CLN-01
Sponsor: Quell Therapeutics Limited (Pharmaceutical company). Phase: Phase I and Phase II (Integrated)- First administration to humans. Countries: Belgium (ongoing, recruitment ended), Spain (ongoing, recruitment ended).
Therapeutic area(s): Phenomena and Processes [G] - Immune system processes [G12]
Gender: Female, Male. Age: 18-64 years, 65+ years. Enrolment: 14.
Status: Ongoing, recruitment ended. Start date (EU): 2023-10-02. Decision date: 2024-09-10. Results received: No. Last updated: 2026-03-11.
Decision dates by country: ES: 2024-09-10, BE: 2024-09-10

Condition(s): Prevention of liver transplant rejection
Product: QEL-001

Primary endpoint: Incidence of protocol-defined Dose-Limiting Toxicities (DLTs) within 28 days post infusion, Incidence and severity of Treatment Emergent Adverse Events (TEAE) including serious adverse events (SAE) according to the Common Terminology Criteria for Adverse Events (CTCAE) version 5.0
Endpoint(s): Proportion of participants that can be successfully withdrawn from IS defined as the percentage of subjects who have stable Liver Function Tests (LFTs) and are IS free for 2 months following Immunosuppression withdrawal, Proportion of participants that can be successfully withdrawn from IS defined as the percentage of subjects who have stable LFTs and are IS free for 1 year following Immunosuppression withdrawal., Incidence and severity of infections from treatment to 1 year post full wean of all immune suppressive medication, Proportion of participants with detectable RCL assessed by polymerase chain reaction (PCR) to vesicular stomatitis virus G glycoprotein (VSV-G) protein [time frame: pre-treatment and Week 14, Week 26 and Week 54], Proportion of participants meeting criteria for operational tolerance defined as (1) successfully withdrawn from IS and remaining IS free for 1 year following Immunosuppression withdrawal; (2) having stable LFTs and (3) meeting histological criteria of operational tolerance, Incidence rate composite efficacy failure from treatment to 1 year following Immunosuppression withdrawal. Composite efficacy failure endpoint is defined as AR, biopsy proven acute rejection (BPAR), reintroduction of IS or graft loss

Source: https://euclinicaltrials.eu/ctis-public/view/2024-516193-30-01